EU clinical trial 2023-504917-54-00: A randomized trial comparing conventional "salvage" radiotherapy and individualized PSMA-PET/CT targeted treatment in patients with biochemical recurrence after prostate cancer surgery
Protocol code: PSMA study
Sponsor: Karolinska University Hospital (Hospital/Clinic/Other health care facility). Phase: Therapeutic confirmatory (Phase III). Countries: Sweden (ongoing, recruiting).
Therapeutic area(s): Diseases [C] - Neoplasms [C04]
Gender: Male. Age: 18-64 years, 65+ years. Enrolment: 450.
Status: Ongoing, recruiting. Start date (EU): 2018-10-30. Decision date: 2023-05-25. Results received: No. Last updated: 2024-10-09.

Condition(s): Biochemical recurrence after prostate cancer surgery
Product: 18F-PSMA-1007, Locametz 25 micrograms kit for radiopharmaceutical preparation

Primary endpoint: Primary PSA progression free survival (PFS) defined as documented biological progression: No response to SRT: the PSA value 3 months after completion of SRT is ≥ 0.1 ng/mL higher than the PSA value just before radiotherapy. Progression after initial response to SRT: Two rising PSA values ≥ 0.1 ng/mL after completion of radiotherapy, with the last value ≥ 0.2 ng/mL.
Endpoint(s): Time to metastasis, Prostate cancer specific survival, Overall survival, Time to secondary treatment: Time from randomization to start of secondary treatment, usually hormonal treatment, Quality of life: All patients fill in PSMA-PROM, a study modified quality of life questionnaire developed by the National PCa Register at baseline and 6, 12, 36, and 60 months after completed treatment.

Source: https://euclinicaltrials.eu/ctis-public/view/2023-504917-54-00